EU clinical trial 2024-512987-74-00: A Randomized, Double-Blind (Sponsor-Unblinded), Placebo-Controlled, Single And Multiple Ascending Dose Study To Evaluate Safety, Tolerability, Pharmacokinetics, Pharmacodynamics, and Bioavailability and Food Effect (Open-Label) of Sage-319 in Healthy Adult Participants.
Protocol code: CHDR2239
Sponsor: Sage Therapeutics Inc. (Pharmaceutical company). Phase: Human Pharmacology (Phase I)- Other. Countries: Netherlands (ended).
Therapeutic area(s): Psychiatry and Psychology [F] - Mental Disorders [F03]
Gender: Female, Male. Age: 18-64 years, 65+ years. Enrolment: 104.
Status: Ended. Start date (EU): 2023-02-27. End date (EU): 2025-10-10. Decision date: 2024-05-02. Results received: No. Last updated: 2024-12-23.

Condition(s): Disorders characterized by a deficit in GABAergic signaling and cerebellar circuitry.

Source: https://euclinicaltrials.eu/ctis-public/view/2024-512987-74-00